EU clinical trial 2024-512939-67-00: Study of safety, tolerability, pharmacokinetics and pharmacodynamics of MSD-001 in healthy participants
Protocol code: MSD001-NL-001
Sponsor: Mindstate Design Labs Inc. (Pharmaceutical company). Phase: Human Pharmacology (Phase I)- First administration to humans. Countries: Netherlands (ended).
Therapeutic area(s): Psychiatry and Psychology [F] - Mental Disorders [F03]
Gender: Female, Male. Age: 18-64 years. Enrolment: 68.
Status: Ended. Start date (EU): 2025-05-10. End date (EU): 2025-07-24. Decision date: 2024-05-22. Results received: No. Last updated: 2025-02-10.

Condition(s): Mental health disorders

Source: https://euclinicaltrials.eu/ctis-public/view/2024-512939-67-00